EU clinical trial 2022-501351-82-00: A Phase IIa, Randomized, Parallel, Double-Blind, Placebo Controlled Study to Evaluate the Efficacy and Safety of Enpatoran in Dermatomyositis and Polymyositis Participants receiving Standard of Care
Protocol code: MS200569_0041
Sponsor: Merck Healthcare KGaA (Pharmaceutical company). Phase: Therapeutic exploratory (Phase II). Countries: Italy (ended), Poland (ended), Czechia (ended), Sweden (ended), Spain (ended), Greece (ended).
Therapeutic area(s): Diseases [C] - Musculoskeletal Diseases [C05]; Diseases [C] - Immune System Diseases [C20]; Diseases [C] - Skin and Connective Tissue Diseases [C17]
Gender: Female, Male. Age: 18-64 years, 65+ years. Enrolment: 15.
Status: Ended. Start date (EU): 2023-05-23. End date (EU): 2025-05-21. End date: 2025-06-25. Decision date: 2023-04-20. Results received: Yes. Last updated: 2025-06-26.
Decision dates by country: SE: 2023-04-20, PL: 2023-04-24, ES: 2023-07-10, IT: 2023-04-20, GR: 2023-04-21, CZ: 2023-04-21

Condition(s): Dermatomyositis, Polymyositis
Product: Enpatoran, Enpatoran placebo

Primary endpoint: DBPC Period: American College of Rheumatology/European League Against Rheumatism (ACR/EULAR) Total Improvement Score (TIS) at Week 24, DBPC Period: Number of Participants with Treatment-Emergent Adverse Events (TEAEs), Serious TEAEs and Adverse Events of Special Interest (AESIs), DBPC Period: Number of Participants with Clinically Significant Changes from Baseline in Laboratory Parameters, Vital Signs and 12-Lead Electrocardiogram (ECG) Measurements
Endpoint(s): DBPC Period: Number of Participants with American College of Rheumatology/European League Against Rheumatism (ACR/EULAR) Total Improvement Score (TIS) Greater Than or Equal to (>=) 20, >= 40 and >= 60, DBPC Period: Total Improvement Score (TIS), DBPC Period: Mean Score for Core Set Measures (CSM) from Week 4 up to Week 24, DBPC Period: Percent Change from Baseline in Most Abnormal Muscle-associated Enzyme at Weeks 4, 8, 12, 16, 20 and 24, DBPC Period: Absolute Change from Baseline in the Core Set Measures (CSM) at Weeks 4, 8, 12, 16, 20 and 24, DBPC Period: Percent Change from Baseline in Core Set Measures (CSM) at Weeks 4, 8, 12, 16, 20 and 24, DBPC Period: Number of Participants with International Myositis Assessment and Clinical Studies (IMACS) Response, DBPC Period: Change from Baseline in Cutaneous Dermatomyositis Disease Area and Severity Index (CDASI) A and CDASI-D at Weeks 4, 8, 12, 16, 20 and 24, DBPC Period: Percent Change from Baseline in Cutaneous Dermatomyositis Disease Area and Severity Index (CDASI) A and CDASI-D at Weeks 4, 8, 12, 16, 20 and 24, DBPC Period: Change from Baseline in Investigator’s Global Assessment (IGA) Skin Activity Score at Weeks 4, 8, 12, 16, 20 and 24, DBPC Period: Percent Change from Baseline in Investigator’s Global Assessment (IGA) Skin Activity Score at Weeks 4, 8, 12, 16, 20 and 24, OLE Period: Number of Participants with Treatment-Emergent Adverse Events (TEAEs), Serious TEAEs and Adverse Events of Special Interest (AESIs), OLE Period: Number of Participants with Clinically Significant Changes from Baseline in Laboratory Parameters, Vital Signs and 12-Lead Electrocardiogram (ECG) Measurements

Source: https://euclinicaltrials.eu/ctis-public/view/2022-501351-82-00